EU clinical trial 2024-511050-44-00: HOVON 146 ALL: Blinatumomab added to prephase and consolidation therapy in precursor B-acute lymphoblastic leukemia in adults. A phase II trial.
Protocol code: HOVON 146 ALL
Sponsor: Hemato-Oncologie voor Volwassenen Nederland (Hovon) Stichting (Hospital/Clinic/Other health care facility). Phase: Therapeutic exploratory (Phase II). Countries: Belgium (ended), Netherlands (ended).
Therapeutic area(s): Diseases [C] - Neoplasms [C04]; Diseases [C] - Hemic and Lymphatic Diseases [C15]
Gender: Female, Male. Age: 18-64 years, 65+ years. Enrolment: 71.
Status: Ended. Start date (EU): 2018-05-16. End date (EU): 2026-05-11. Decision date: 2024-11-12. Results received: No. Last updated: 2024-11-20.
Decision dates by country: BE: 2024-11-20, NL: 2024-11-12

Condition(s): Precursor B-acute lymphoblastic leukemia
Product: BLINCYTO 38.5 micrograms powder for concentrate and solution for solution for infusion

Primary endpoint: Proportion of MRD negative response by PCR/FCM after the first blinatumomab consolidation course. MRD negative response is defined as MRD <10^-4 by PCR or FCM
Endpoint(s): MRD level following induction chemotherapy, MRD level after second blinatumomab consolidation, Hematological response after induction, blinatumomab consolidation I and blinatumomab consolidation II, Event-free survival, i.e. time from registration until no CR on protocol, relapse or death from any cause, whichever comes first. EFS for patients without a CR on protocol will be set at 1 day; this also includes patients with a first CR only after start intensification 1. Patients still in first CR and alive are censored at the last day they were last known to be alive., Relapse-free survival (hematologically; i.e. time from CR on protocol until relapse or death from any cause, whichever comes first). Patients still in first CR and alive are censored at the last day they were last known to be alive., Overall survival, measured from the time of registration until death from any cause. Patients still alive or lost to follow up are censored at the date they were last known to be alive., Adverse events, RFS and OS from start allogeneic transplantation and from start maintenance RFS, whichever is applicable, T-cell and B-cell kinetics and assessment of predictive value, Comparison of the results of molecular and flowcytometric MRD measurements at the same timepoints (sidestudy)

Source: https://euclinicaltrials.eu/ctis-public/view/2024-511050-44-00